EU clinical trial 2022-500275-31-00: A phase 3b open-label, multicenter study evaluating physical activity and joint health in previously treated patients ≥12 years of age with severe haemophilia A treated with intravenous recombinant coagulation factor VIII Fc-von Willebrand Factor-XTEN fusion protein (rFVIIIFc-VWF-XTEN; efanesoctocog alfa) for 24 months
Protocol code: Sobi.BIVV001-001
Sponsor: Swedish Orphan Biovitrum AB (publ) (Pharmaceutical company). Phase: Therapeutic confirmatory (Phase III). Countries: Croatia (ended), Norway (ended), Italy (ended), Czechia (ended), France (ended), Sweden (ended), Spain (ended), Austria (ended), Belgium (ended), Greece (ended), Slovenia (ended), Ireland (ended), Netherlands (ended), Germany (ended).
Therapeutic area(s): Diseases [C] - Hemic and Lymphatic Diseases [C15]
Gender: Female, Male. Age: 0-17 years, 18-64 years, 65+ years. Enrolment: 81.
Status: Ended. Start date (EU): 2023-06-20. End date (EU): 2026-06-02. End date: 2026-06-03. Decision date: 2023-02-28. Results received: No. Last updated: 2025-11-12.
Decision dates by country: BE: 2023-03-06, IT: 2023-05-17, HR: 2023-03-01, GR: 2023-02-28, IE: 2023-03-03, DE: 2023-05-26, AT: 2023-03-02, SE: 2023-02-28, FR: 2023-03-06, NL: 2023-02-28, ES: 2023-03-01, SI: 2023-03-01, NO: 2023-03-01, CZ: 2023-03-03

Condition(s): Haemophilia A
Product: BIVV001 - efanesoctocog alfa, BIVV001 - efanesoctocog alfa, BIVV001 - efanesoctocog alfa, BIVV001 - efanesoctocog alfa, BIVV001 - efanesoctocog alfa

Primary endpoint: Change from baseline in IPAQ scoring [at month 24]
Endpoint(s): Physical activity • Change from baseline in IPAQ scoring [at month 12] • IPAQ score • Change in mean daily minutes of tracker-recorded physical activity • Mean daily minutes of tracker-recorded physical activity, • Change in patient-reported workout • Change in tracker-recorded workout • Mean value in patient-reported workout • Mean value in tracker-recorded workout • Change in mean daily number of tracker-recorded steps, • Mean daily number of tracker-recorded steps • Achieving WHO-recommended levels (33) of tracker-recorded MVPA • Occurrence of bleeds • Occurrence of pain • Occurrence of injuries • Occurrence of bleeding episodes impacting daily activity (Missed work/school, missed other activities, nothing missed), Joint & musculoskeletal status • Change from baseline in HJHS and HEAD-US and MRI at a total/joint and item domain level. • Target joint development, resolution and recurrence, Efanesoctocog alfa efficacy • Number of bleeding episodes • ABR by type and location • Total annualized efanesoctocog alfa consumption • Number of injections and dose to treat a bleeding episode, PROs • Pain (ePD reported, PROMIS Pain Intensity, PROMIS-SF Pain Interference) • QoL assessed by EQ-5D-5L • Treatment Preference Survey [EoS], Safety • The occurrence of AEs and SAEs • The occurrence of clinically significant changes from baseline in physical examination • Development of inhibitors (neutralizing antibodies directed against factor VIII [FVIII]) as determined via the Nijmegen modified Bethesda assay • The occurrence of thrombotic and embolic events, Healthcare Resources • Number and duration of non-study medical care encounters (outpatient, inpatient, emergency room)

Source: https://euclinicaltrials.eu/ctis-public/view/2022-500275-31-00